EU clinical trial 2024-517402-28-00: Role of antibiotics in conjunction with oral bone augmentation procedures (BAS20)
Sponsor: Karolinska Institutet (Educational Institution). Phase: Therapeutic exploratory (Phase II). Countries: Sweden (ongoing, recruiting).
Therapeutic area(s): Diseases [C] - Bacterial Infections and Mycoses [C01]
Gender: Female, Male. Age: 18-64 years, 65+ years. Enrolment: 80.
Status: Ongoing, recruiting. Start date (EU): 2023-10-01. Decision date: 2024-11-05. Results received: No. Last updated: 2025-08-18.

Condition(s): Need of Oral bone augmentation
Product: Amimox 500 mg filmdragerade tabletter, Kåvepenin 800 mg filmdragerade tabletter

Primary endpoint: Occurrence of postoperative infection, which will be determined by evaluating the following parameters, Pus in surgical field (absolute indication of infection). Defined as discoloured exudate from surgical wound., Occurrence of fistula in surgical field (absolute indication of infection). Defined as communication between oral cavity and implanted material through confirmed by using gingival pocket probe., Swelling in surgical field (relative indication of infection and requires occurrence of one or more of the absolute indications). Defined as objective pathologic increase in tissue volume over surgical field compared to contralateral side or normal condition., Pain (relative indication of infection and requires occurrence of one or more of the absolute indications). Subjective report of local pain in surgical field.
Endpoint(s): Survival of augmented material, Survival of dental implant (if applicable), Dehiscence of bone augmented area., Quantitative and qualitative change in levels of the oral and faecal microflora., Changes in occurrence of antibiotic resistance in the oral and faecal microflora.

Source: https://euclinicaltrials.eu/ctis-public/view/2024-517402-28-00